EU clinical trial 2025-522491-89-00: Efficacy and safety of SP16 in preventing Acute Kidney Injury in at-risk subjects with chronic kidney disease undergoing elective cardiac surgery using the heart-lung-machine: A prospective, randomized, double-blind, placebo-controlled clinical trial (EASE-AKI)
Protocol code: UKER-SP16-AKI-01
Sponsor: Universitaetsklinikum Erlangen AöR (Hospital/Clinic/Other health care facility). Phase: Therapeutic exploratory (Phase II). Countries: Germany (authorised, recruitment pending).
Therapeutic area(s): Diseases [C] - Cardiovascular Diseases [C14]; Not possible to specify
Gender: Female, Male. Age: 18-64 years, 65+ years. Enrolment: 120.
Status: Authorised, recruitment pending. Decision date: 2026-02-02. Results received: No. Last updated: 2026-06-09.

Condition(s): Cardiovascular Disease, Valvular Disease, Chronic Kidney Disease

Primary endpoint: Primary safety endpoint: Frequency of AEs and SAEs within 72 h after index surgery., Primary efficacy endpoint: Number of participants who develop CSA-AKI during hospital stay defined by KDIGO stage 1 or higher.
Endpoint(s): Highest CSA-AKI stage value according to the stage classification of the KDIGO-AKI in the 7-day period after the index surgery., Number of days after post-surgical onset of CSA-AKI until re-achievement of baseline level of serum creatinine (defined as a return of creatinine to <0.3 mg/dl above baseline value) or discharge from hospital, whichever comes first., Necessity of RRT (yes/no), Duration of RRT measured by starting date [yyyy-mmm-dd] and end date [yyyy-mmm-dd], Cardiac function on Day 90±7 d after cardiac index surgery compared to pre surgical assessment (Visit 1) assessed by echocardiography (TTE)., Cardiac function on Day 0 post-surgery (Visit 3), Day 1, and on Day 5 after index surgery assessed by point of care echocardiography (TTE) compared to pre-surgical assessment (Visit 1)., NT-proBNP level on Day 1, Day 7, and Day 90±7 d after index surgery compared to pre-surgical assessment on Day 0 (Baseline; Visit 2)., Central venous oxygen saturation (ScvO2) on Day 1, Day 5 and Day 7 after index surgery compared to pre-surgical assessment on Day 0 (Baseline; Visit 2)., All-cause death within 90±7d (3 months) after cardiac index surgery., Sustained impaired renal function defined as ≥25% increase in SCr at Day 90±7 d compared to baseline., Sustained impaired renal function requiring at least one dialysis during the post-surgical interval until Day 90±7 d (end of observation period)., Frequency of AE and SAE within 7 days after cardiac index surgery., Frequency of AE and SAE during the observation period., Number of participants with at least one SAE during the observation period.

Source: https://euclinicaltrials.eu/ctis-public/view/2025-522491-89-00